EU clinical trial 2023-509937-37-00: A 5- year randomized, double-blind, placebo-controlled, multi-center study assessing the efficacy, safety, and tolerability of intra-articular regimens of LNA043 versus placebo in patients with symptomatic knee osteoarthritis (ONWARDS)
Protocol code: CLNA043A12202
Sponsor: Novartis Pharma AG (Pharmaceutical company). Phase: Therapeutic exploratory (Phase II). Countries: Spain (ended), Poland (ended), Denmark (ended), Estonia (ended), Czechia (ended).
Therapeutic area(s): Diseases [C] - Musculoskeletal Diseases [C05]
Gender: Female, Male. Age: 18-64 years, 65+ years. Enrolment: 250.
Status: Ended. Start date (EU): 2021-07-21. End date (EU): 2025-05-27. End date: 2025-05-29. Decision date: 2024-05-16. Results received: Yes. Last updated: 2024-11-27.
Decision dates by country: DK: 2024-05-16, PL: 2024-05-21, EE: 2024-05-20, CZ: 2024-05-16, ES: 2024-05-16

Condition(s): Osteoarthritis
Product: LNA043

Primary endpoint: Change from baseline in the knee structure
Endpoint(s): Change from baseline in Western Ontario and McMaster Universities Osteoarthritis Index (WOMAC) pain, Change from baseline in Western Ontario and McMaster Universities Osteoarthritis Index (WOMAC) function, Change from baseline in cartilage structure, Change from baseline in physical function, Proportion of participants demonstrating structural progression, Assessing adverse events and serious adverse events

Source: https://euclinicaltrials.eu/ctis-public/view/2023-509937-37-00